EU clinical trial 2025-523630-59-00: Double-blind, randomized, placebo-controlled, study to evaluate the safety and efficacy of HRX215 in participants after major hepatectomy, preceded by two open pilot parts in participants after minor and after major hepatectomy due to colon carcinoma metastases
Protocol code: HRX215-CR03-LR01
Sponsor: HepaRegeniX GmbH (Pharmaceutical company). Phase: Phase I and Phase II (Integrated)- Other. Countries: France (authorised, recruiting), Spain (authorised, recruiting), Germany (authorised, recruiting).
Therapeutic area(s): Diseases [C] - Neoplasms [C04]
Gender: Female, Male. Age: 18-64 years, 65+ years. Enrolment: 40.
Status: Authorised, recruiting. Start date (EU): 2026-06-12. Decision date: 2026-04-20. Results received: No. Last updated: 2026-05-07.
Decision dates by country: FR: 2026-04-23, DE: 2026-04-20, ES: 2026-04-27

Condition(s): colon carcinoma metastases
Product: HRX215, White opaque capsules, size 1

Primary endpoint: Incidence, severity, and relatedness of AEs/SAEs, Changes from baseline in vital signs and physical examination findings, Changes from baseline in clinical laboratory parameters (hematology,blood, glucose) at prespecified time points, Plasma PK of HRX215 (Cmax, Tmax, AUC etc.); comparison with Phase 1 healthy-subject PK data
Endpoint(s): Establishment of Efficacy (main study part 3): • Liver volume on POD1 and POD7 and increase in liver volume at POD7 vs. POD1 (absolute change from POD1 CT)

Source: https://euclinicaltrials.eu/ctis-public/view/2025-523630-59-00